EU clinical trial 2025-521577-13-00: A phase 1b study of an autologous dendritic cell immunotherapy in combination with anti-programmed death-1 treatment in patients with metastatic non-small-cell lung cancer (DARE-LUNG)
Protocol code: DARE-LUNG
Sponsor: Universitair Ziekenhuis Gent (Hospital/Clinic/Other health care facility). Phase: Human Pharmacology (Phase I)- First administration to humans. Countries: Belgium (authorised, recruitment pending).
Therapeutic area(s): Diseases [C] - Neoplasms [C04]
Gender: Female, Male. Age: 18-64 years, 65+ years. Enrolment: 64.
Status: Authorised, recruitment pending. Decision date: 2025-08-25. Results received: No. Last updated: 2025-09-11.

Condition(s): metastatic non-small-cell lung cancer
Product: Carboplatin Accord 10 mg/ml, concentraat voor oplossing voor infusie, Paclitaxel Fresenius Kabi 6 mg/ml concentraat voor oplossing voor infusie, Cisplatine Accord 1 mg/ml concentraat voor oplossing voor infusie, LIBTAYO 350 mg concentrate for solution for infusion., MIDRIX-LUNG-002, Pemetrexed Accord 500 mg powder for concentrate for solution for infusion., KEYTRUDA 25 mg/mL concentrate for solution for infusion, Pemetrexed Accord 500 mg powder for concentrate for solution for infusion., Pemetrexed Accord 1000 mg powder for concentrate for solution for infusion., Cisplatine Accord 1 mg/ml concentraat voor oplossing voor infusie, Cisplatine Accord 1 mg/ml concentraat voor oplossing voor infusie, Pemetrexed Accord 100 mg powder for concentrate for solution for infusion., Pemetrexed Accord 100 mg powder for concentrate for solution for infusion., Pemetrexed Accord 1000 mg powder for concentrate for solution for infusion., Paclitaxel Fresenius Kabi 6 mg/ml concentraat voor oplossing voor infusie, KEYTRUDA 25 mg/mL concentrate for solution for infusion, Paclitaxel Fresenius Kabi 6 mg/ml concentraat voor oplossing voor infusie, Carboplatin Accord 10 mg/ml, concentraat voor oplossing voor infusie, Pemetrexed Accord 1000 mg powder for concentrate for solution for infusion., LIBTAYO 350 mg concentrate for solution for infusion., KEYTRUDA 25 mg/mL concentrate for solution for infusion, LIBTAYO 350 mg concentrate for solution for infusion., LIBTAYO 350 mg concentrate for solution for infusion., Paclitaxel Fresenius Kabi 6 mg/ml concentraat voor oplossing voor infusie, Pemetrexed Accord 100 mg powder for concentrate for solution for infusion., Paclitaxel Fresenius Kabi 6 mg/ml concentraat voor oplossing voor infusie, Carboplatin Accord 10 mg/ml concentraat voor oplossing voor infusie, KEYTRUDA 25 mg/mL concentrate for solution for infusion, Carboplatin Accord 10 mg/ml concentraat voor oplossing voor infusie, Pemetrexed Accord 1000 mg powder for concentrate for solution for infusion., MIDRIX-LUNG-001, Paclitaxel Fresenius Kabi 6 mg/ml concentraat voor oplossing voor infusie, Paclitaxel Fresenius Kabi 6 mg/ml concentraat voor oplossing voor infusie, Pemetrexed Accord 100 mg powder for concentrate for solution for infusion., Pemetrexed Accord 500 mg powder for concentrate for solution for infusion., Cisplatine Accord 1 mg/ml concentraat voor oplossing voor infusie, Paclitaxel Fresenius Kabi 6 mg/ml concentraat voor oplossing voor infusie, Paclitaxel Fresenius Kabi 6 mg/ml concentraat voor oplossing voor infusie, Paclitaxel Fresenius Kabi 6 mg/ml concentraat voor oplossing voor infusie

Primary endpoint: Toxicity as defined by the Common Toxicity Criteria for Adverse Events version 5.0 (CTCAE v.5.0). Toxicity will be assessed during the interventional treatment phase of the trial from leukapheresis until three months after the last vaccine dose.
Endpoint(s): Overall response rate (ORR%) based on investigator assessment per Response Evaluation Criteria in Solid Tumors (RECIST) v1.1; duration of response; median progression-free survival (mPFS, months); 1-year PFS (%) based on investigator assessment per RECIST 1.1; median overall survival (mOS, months); 1-year OS (%)., Vaccine-induced immune responses as measured by in vitro immunomonitoring tests (antigen-specific T-cell reactivity). Immune responses will be measured after each DC vaccination and at prespecified timepoints during the follow-up period., Success rate (%) of manufacturing sufficient DCs for vaccination, which is defined as the production of DC aliquots for ≥ 3 vaccination rounds., Health-related quality of life by means of the EORTC QLQ-C30 and EORTC QLQ-LC29 questionnaires, measured before and during the interventional treatment phase of the trial.

Source: https://euclinicaltrials.eu/ctis-public/view/2025-521577-13-00